EU clinical trial 2023-503272-25-00: Phase 2, open-label, single-arm rollover study to evaluate long-term Safety in subjects who participated in other Celgene sponsored CC-486 (oral Azacitidine) clinical trials in Hematological disorders
Protocol code: CC-486-GEN-001
Sponsor: Celgene Corp. (Pharmaceutical company). Phase: Therapeutic exploratory (Phase II). Countries: Finland (ended).
Therapeutic area(s): Diseases [C] - Hemic and Lymphatic Diseases [C15]
Gender: Female, Male. Age: 18-64 years, 65+ years. Enrolment: 1.
Status: Ended. End date (EU): 2025-04-14. End date: 2025-04-15. Decision date: 2023-09-07. Results received: Yes. Last updated: 2024-05-28.

Condition(s): Hematological Disorders
Product: azacitidine 200 mg tablet, azacitidine 150 mg tablet, azacitidine 300 mg tablet, azacitidine 100 mg tablet

Primary endpoint: Safety: type, frequency, severity, and relationship of treatment emergent adverse events (AEs) to investigational product (CC-486).
Endpoint(s): Survival: time from randomization until death from any cause.

Source: https://euclinicaltrials.eu/ctis-public/view/2023-503272-25-00